EU clinical trial 2024-516590-75-00: Exploratory study evaluating the potential of immune signature profiling for predicting response in patients with resectable Stage II, IIIA and select IIIB (T3N2 only) non-squamous Non-Small Cell Lung Cancer (NSCLC) to neoadjuvant ATEZOLIZUMAB plus Carboplatin/Nab Paclitaxel (IReP)
Protocol code: IReP
Sponsor: Universitaetsklinikum Heidelberg AöR (Hospital/Clinic/Other health care facility). Phase: Therapeutic exploratory (Phase II). Countries: Germany (ongoing, recruitment ended).
Therapeutic area(s): Diseases [C] - Respiratory Tract Diseases [C08]
Gender: Female, Male. Age: 18-64 years, 65+ years. Enrolment: 20.
Status: Ongoing, recruitment ended. Start date (EU): 2021-02-22. Decision date: 2024-09-18. Results received: No. Last updated: 2024-09-18.

Condition(s): Lung cancer
Product: Abraxane 5 mg/ml powder for dispersion for infusion., Carboplatin Kabi 10 mg/ml Konzentrat zur Herstellung einer Infusionslösung, Tecentriq 1 200 mg concentrate for solution for infusion

Primary endpoint: Response to neoadjuvant immunochemotherapy with ATEZOLIZUMAB, Carboplatin and nab- Paclitaxel as determined by Major Pathologic Response (MPR) (≤10% residual viable tumor cells) (pathologic regression grading according to Junker criteria) rate
Endpoint(s): Response rate as determined by Δ tumor size and Δ lymph node size according to RECIST 1.1 criteria, Response rate as determined by Δ PETactivity (standardized uptake value [SUV]), Event-free survival (EFS) ● calculated from start of 1st cycle of neoadjuvant treatment ● follow-up for 24 months after end of treatment visit; end of treatment visit takes place 6 weeks after surgery, Overall survival (OS) ● calculated from start of 1st cycle of neoadjuvant treatment ● follow-up for 24 months after end of treatment visit; end of treatment visit takes place 2-6 weeks after surgery, Number of patients attaining surgery as planned

Source: https://euclinicaltrials.eu/ctis-public/view/2024-516590-75-00